EU clinical trial 2024-512821-10-00: ABCSG 45: A prospective, open, randomized, phase II study of carboplatin/olaparib in the pre-operative treatment of patients with triple-negative primary breast cancer which exhibit the features of positive homologous recombination deficiency (HRD) status
Protocol code: ABCSG 45
Sponsor: Verein Zur Praevention Und Therapie Boesartiger Erkrankungen Austrian Breast And Colorectal Cancer Study Group (Patient organisation/association). Phase: Therapeutic exploratory (Phase II). Countries: Austria (ended).
Therapeutic area(s): Diseases [C] - Neoplasms [C04]
Gender: Female, Male. Age: 18-64 years, 65+ years. Enrolment: 90.
Status: Ended. Start date (EU): 2019-06-17. End date (EU): 2025-09-05. Decision date: 2024-04-26. Results received: No. Last updated: 2025-01-15.

Condition(s): Early invasive triple negative breast cancer with positive HRD status (acc. to Myriad mychoice© test)
Product: Lynparza 100 mg film-coated tablets, CYCLOPHOSPHAMIDE, Lynparza 150 mg film-coated tablets, DOCETAXEL, DOXORUBICIN, CARBOPLATIN, EPIRUBICIN

Primary endpoint: Main study: Histo-pathological response to pre-operative carboplatin/olaparib compared with pre-operative TAC-based chemotherapy when measured by centrally assessed RCB (RCB-0/I versus RCB-II/III)., Substudy: Incidence, nature and severity of adverse events (AEs) graded according to NCI CTCAE, most current version.
Endpoint(s): Main study: Occurrence of pCR at the time of surgery., Main study: Quality of Life and sexual health scores and changes from baseline as measured using EORTC QLQ-C30, EORTC QLQ-BR45 and EORTC SHQ-C22.

Source: https://euclinicaltrials.eu/ctis-public/view/2024-512821-10-00